EU clinical trial 2022-501133-23-00: Migraine and High Flow Oxygenotherapy at the Emergency Department (MiOx)
Sponsor: Centre Hospitalier Universitaire De Nice (Hospital/Clinic/Other health care facility). Phase: Therapeutic exploratory (Phase II). Countries: France (ongoing, recruiting).
Therapeutic area(s): Diseases [C] - Nervous System Diseases [C10]
Gender: Female, Male. Age: 18-64 years, 65+ years. Enrolment: 70.
Status: Ongoing, recruiting. Start date (EU): 2023-05-11. Decision date: 2023-01-11. Results received: No. Last updated: 2025-02-05.

Condition(s): MIGRAINE
Product: Oxigen medicinal comprimat gaz medicinal comprimat, Medicinal Air Synthetic, 21.75% v/v medicinal gas, compressed

Primary endpoint: PProportion of subjects with a score less than or equal to 3 on the Simple Numerical Scale (SLA) of verbal self-assessment of patient pain (0-10), 30 minutes after the start of inhaled treatment.
Endpoint(s): Disappearance of any associated symptoms (nausea, photophobia, etc.): frequencies at t=0, 30, 60 and 90 minutes after the start of the oxygen or placebo session (air), Verbal Patient Pain Self-Assessment SLAs at 60 and 90 minutes (assess possible recurrence of pain), Frequency of occurrence of side effects, Average time spent in emergency rooms, Frequency of emergency painkillers

Source: https://euclinicaltrials.eu/ctis-public/view/2022-501133-23-00